EU clinical trial 2024-514972-42-00: VRDN-003-301: A phase 3, randomized, double-masked, placebo-controlled, efficacy, safety, and tolerability study of VRDN-003 in participants with active thyroid eye disease (TED)
Protocol code: VRDN-003-301
Sponsor: Viridian Therapeutics Inc. (Pharmaceutical company). Phase: Therapeutic confirmatory (Phase III). Countries: Hungary (ongoing, recruitment ended), Spain (ongoing, recruitment ended), Poland (not authorised), Germany (ongoing, recruitment ended), Netherlands (ongoing, recruitment ended).
Therapeutic area(s): Diseases [C] - Eye Diseases [C11]
Gender: Female, Male. Age: 18-64 years, 65+ years. Enrolment: 54.
Start date (EU): 2025-02-25. Decision date: 2025-02-11. Results received: No. Last updated: 2026-05-11.
Decision dates by country: PL: 2025-02-17, DE: 2025-02-11, HU: 2025-02-13, ES: 2025-02-12, NL: 2025-02-12

Condition(s): Thyroid eye disease
Product: VRDN (Insulin-like growth factor-1 receptor [IGF-1R] inhibitor with half-life extension), TED SC Placebo

Primary endpoint: The primary study endpoint will assess the percentage of participants who have a response called Overall Responder Rate at Week 24. An Overall Responder is a participant who achieves a ≥ 2 mm reduction in eye bulging AND shows a reduction in Clinical Activity Score or CAS (that is an estimate of disease severity/symptoms) ≥ 2 points at Week 24 versus measurements before the first dose.
Endpoint(s): The secondary endpoints will assess changes in eye bulging, disease severity and symptoms versus measurements before the first dose, and percent of participants who achieve the required reduction in eye bulging, disease severity and symptoms, and reduction and resolution of double vision at Week 24., Safety Endpoint: the study will also evaluate safety events (side effects), the effects of VRDN-003 on the body and vice-versa throughout the study.

Source: https://euclinicaltrials.eu/ctis-public/view/2024-514972-42-00